EU clinical trial 2024-516273-80-00: Personalized therapy of metastatic thyroid cancer: biological characterization and optimization with 124I PET dosimetry
Protocol code: AIRC Id. 21939
Sponsor: Fondazione IRCCS Istituto Nazionale Dei Tumori (Hospital/Clinic/Other health care facility). Phase: Therapeutic exploratory (Phase II). Countries: Italy (ongoing, recruiting).
Therapeutic area(s): Diseases [C] - Pathological Conditions, Signs and Symptoms [C23]
Gender: Female, Male. Age: 18-64 years, 65+ years. Enrolment: 50.
Status: Ongoing, recruiting. Start date (EU): 2021-05-12. Decision date: 2024-10-16. Results received: No. Last updated: 2024-10-16.

Condition(s): Metastatic DTC
Product: Sodio ioduro (I131) Curium Netherlands 37-7400 MBq capsula rigida

Primary endpoint: Evaluation of complete response (CR) rate on soft tissue metastases after a maximum of two radioiodine administrations optimized with personalized pre-treatment dosimetry based on 124I-PET/CT. The response will be considered 6 months [1] after the last optimized administration, as a combination of evaluations (RECIST, 124I-PET/CT, 18F-FDG, and thyroglobulin).
Endpoint(s): Assessment of acute toxicity rate and severity, Assessment of the association among pre-treatment glucose metabolism, 124I uptake and therapy response, Assessment of the association among genetic mutations on cancer tissue, pre- and post-treatment miRNA expression, pre- and post-treatment glucose metabolism, iodine uptake, and 131I therapy response

Source: https://euclinicaltrials.eu/ctis-public/view/2024-516273-80-00